EU clinical trial 2023-504412-14-00: A Study to Investigate the Safety, Tolerability, Pharmacokinetics and Pharmacodynamics of RO7486967 in Participants with Early Idiopathic Parkinson’s Disease
Protocol code: BP43176
Sponsor: F. Hoffmann-La Roche AG (Pharmaceutical company). Phase: Human Pharmacology (Phase I)- Other. Countries: Netherlands (ended).
Therapeutic area(s): Diseases [C] - Nervous System Diseases [C10]
Gender: Female, Male. Age: 18-64 years, 65+ years. Enrolment: 20.
Status: Ended. Start date (EU): 2022-09-01. End date (EU): 2024-07-18. Decision date: 2023-08-22. Results received: No. Last updated: 2023-12-20.

Condition(s): Early Idiopathic Parkinson’s Disease (PD)

Source: https://euclinicaltrials.eu/ctis-public/view/2023-504412-14-00